EU clinical trial 2024-511304-16-00: A Phase 2 Randomized, Open Label Study to Evaluate the Efficacy and Safety of Golcadomide in Combination with Rituximab in Patients with Newly Diagnosed Advanced Stage Follicular Lymphoma
Protocol code: CA073-1022
Sponsor: Celgene Corp. (Pharmaceutical company). Phase: Therapeutic exploratory (Phase II). Countries: Poland (ongoing, recruitment ended), Italy (ongoing, recruitment ended), Spain (ongoing, recruitment ended), France (ongoing, recruitment ended), Germany (ongoing, recruitment ended).
Therapeutic area(s): Diseases [C] - Hemic and Lymphatic Diseases [C15]
Gender: Female, Male. Age: 18-64 years, 65+ years. Enrolment: 37.
Status: Ongoing, recruitment ended. Start date (EU): 2024-10-10. Decision date: 2024-09-24. Results received: No. Last updated: 2026-07-24.
Decision dates by country: PL: 2024-09-30, DE: 2024-09-26, IT: 2024-09-24, FR: 2024-09-25, ES: 2024-09-25

Condition(s): Newly Diagnosed Advanced Stage Follicular Lymphoma
Product: Golcadomide, CYCLOPHOSPHAMIDE, RITUXIMAB, Golcadomide, RITUXIMAB, PREDNISOLONE, PREDNISONE, Golcadomide, BENDAMUSTINE HYDROCHLORIDE, VINCRISTINE SULFATE, VINCRISTINE SULFATE, DOXORUBICIN, Golcadomide, PEGFILGRASTIM

Primary endpoint: To evaluate if the patient´s condition improves using CMR. This means that at different times during the treatment, such as 6 months or 12 months after the start of treatment, the person's disease has completely responded to the treatment.
Endpoint(s): To evaluate any negative side effects or adverse events (AE), which means an occurrence that has a negative impact on the health or well-being of a participant. This includes any new side effects that start after the treatment begins, which we call "Treatment-Emergent Adverse Events" (TEAEs)., To evaluate all AE, including TEAE and laboratory test as well as CMR data collected during the treatment of the Golcadomide and rituximab combination., To evaluate the overall response rate (ORR), the percentage of participants whose cancer shrinks or disappears., To evaluate PFS, the time from when we start the treatment until the disease gets worse or the patient passes away., To evaluate OS, which is the time from when we start the treatment until the patient passes away., To evaluate all AE, including TEAE and laboratory test as well as CMR, ORR, PFS and OS data collected during the treatment of the rituximab and chemotherapy combination.

Source: https://euclinicaltrials.eu/ctis-public/view/2024-511304-16-00